EU clinical trial 2025-523340-12-00: Repurposed Drugs in Research and Cancer Clinical Trials. The ReDiReCCT trial Vemurafenib
Protocol code: 14341
Sponsor: Erasmus Universitair Medisch Centrum Rotterdam (Erasmus MC) (Hospital/Clinic/Other health care facility). Phase: Human Pharmacology (Phase I)- Other. Countries: Netherlands (authorised, recruitment pending).
Therapeutic area(s): Diseases [C] - Neoplasms [C04]
Gender: Female, Male. Age: 18-64 years, 65+ years. Enrolment: 18.
Status: Authorised, recruitment pending. Decision date: 2025-12-09. Results received: No. Last updated: 2025-12-09.

Condition(s): Glioma

Source: https://euclinicaltrials.eu/ctis-public/view/2025-523340-12-00